EU clinical trial 2026-525906-37-00: Montelukast as disease modifying treatment in mild-moderate Parkinson’s disease, an open-label, phase II extension trial (MONTPARK_OLE)
Sponsor: Karolinska University Hospital (Hospital/Clinic/Other health care facility). Phase: Therapeutic confirmatory (Phase III). Countries: Sweden (authorised, recruitment pending).
Therapeutic area(s): Diseases [C] - Nervous System Diseases [C10]
Gender: Female, Male. Age: 18-64 years, 65+ years. Enrolment: 98.
Status: Authorised, recruitment pending. Decision date: 2026-06-03. Results received: No. Last updated: 2026-06-03.

Condition(s): Parkinson's Disease
Product: MONTELUKAST

Primary endpoint: The primary endpoint is the rate and severity of AE including abnormal laboratory values. The rate will be compared to active and placebo arm of the original MONTPARK trial. AE will be documented at each visit but also continuously as needed.
Endpoint(s): MDS-UPDRS Part 3, MDS-UPDRS parts 1, 2 and 4, Montreal Cognitive Assessment (MoCA), The Clinical Impression of Severity Index for Parkinson's Disease (CISI-PD), The Parkinson’s Disease Questionnaire (PDQ)-8, Hospital Anxiety and Depression Scale (HAD), The Non-Motor Symptoms Questionnaire (NMSQ)

Source: https://euclinicaltrials.eu/ctis-public/view/2026-525906-37-00